EU clinical trial 2022-502882-53-00: Long Acting Cabotegravir plus Rilpivirine in People Living with HIV-1 (PLHIV) Aged ≥ 60 Years for 24 months.
Protocol code: IMIB-LOVER60-2022-03
Sponsor: Fundacion Para La Formacion E Investigacion Sanitaria De La Region De Murcia (Educational Institution). Phase: Therapeutic use (Phase IV). Countries: Spain (ongoing, recruitment ended).
Therapeutic area(s): Diseases [C] - Virus Diseases [C02]; Diseases [C] - Immune System Diseases [C20]
Gender: Female, Male. Age: 18-64 years, 65+ years. Enrolment: 120.
Status: Ongoing, recruitment ended. Start date (EU): 2025-03-03. Decision date: 2025-01-15. Results received: No. Last updated: 2026-08-03.

Condition(s): HIV-1
Product: Vocabria 600 mg prolonged-release suspension for injection, REKAMBYS 900 mg prolonged-release suspension for injection

Primary endpoint: Proportion of PLHIV ≥ 60 years on stable ART that switch to CAB LA + RPV LA with plasma HIV-1 RNA ≥50 copies per mL at month 12 in the intention-to-treat exposed (ITT-E) population, per the US Food and Drug Administration’s Snapshot algorithm.

Source: https://euclinicaltrials.eu/ctis-public/view/2022-502882-53-00